EU clinical trial 2023-508230-33-00: A randomized, Phase 1b, single-center, observer-blind, active-controlled study to evaluate the safety, immunogenicity, and immunological mechanisms of one single administration of TETRALITE influenza vaccine at two dose levels of LiteVax Adjuvant, in healthy participants aged 60 years and older and in healthy participants aged 18 to 50 years.
Protocol code: TETRALITE-Ib
Sponsor: LiteVax B.V. (Pharmaceutical company). Phase: Human Pharmacology (Phase I)- Other. Countries: Belgium (ended).
Therapeutic area(s): Diseases [C] - Virus Diseases [C02]
Gender: Female, Male. Age: 18-64 years, 65+ years. Enrolment: 70.
Status: Ended. Start date (EU): 2024-01-12. End date (EU): 2024-10-10. Decision date: 2023-12-22. Results received: No. Last updated: 2023-12-22.

Condition(s): Influenza

Source: https://euclinicaltrials.eu/ctis-public/view/2023-508230-33-00